EU clinical trial 2024-512558-40-00: Randomized, Double-Blind, Placebo-Controlled, Phase 2 Study of VE202 in Patients with Mild-to-Moderate Ulcerative Colitis
Protocol code: VE202-002
Sponsor: Vedanta Biosciences Inc. (Pharmaceutical company). Phase: Therapeutic exploratory (Phase II). Countries: Netherlands (ended), Czechia (ended), Hungary (ended), Bulgaria (ended), Lithuania (ended), Poland (ended).
Therapeutic area(s): Diseases [C] - Digestive System Diseases [C06]
Gender: Female, Male. Age: 18-64 years, 65+ years. Enrolment: 74.
Status: Ended. Start date (EU): 2023-05-11. End date (EU): 2025-08-11. End date: 2025-08-12. Decision date: 2024-10-11. Results received: No. Last updated: 2025-07-28.
Decision dates by country: LT: 2024-10-23, NL: 2024-10-14, PL: 2024-10-13, CZ: 2024-10-15, HU: 2024-10-11, BG: 2024-10-22

Condition(s): Mild-to-moderate ulcerative colitis
Product: VANCOMYCIN HYDROCHLORIDE, VE202, VE202 Placebo drug product (DP) is microcrystalline cellulose filled into a size 0 Vcaps® Enteric-coated capsule.

Primary endpoint: Endoscopic response rate defined as a reduction of 1 point or more in Mayo endoscopic subscore on flexible sigmoidoscopy from baseline to Day 56, Grade ≥ 3 Treatment-emergent adverse event (TEAEs) that are related to VE202 or VE202 placebo, Serious adverse event (SAEs) that are related to VE202 or VE202 placebo, OPEN-LABEL PORTION (PART 4): TEAEs, SAEs, AESIs, MAAEs

Source: https://euclinicaltrials.eu/ctis-public/view/2024-512558-40-00